EU clinical trial 2023-506924-94-00: The cardiovascular safety and efficacy of cagrilintide 2.4 mg s.c. in combination with semaglutide 2.4 mg s.c. (CagriSema 2.4 mg/2.4 mg s.c.) once-weekly in participants with established cardiovascular disease
Protocol code: NN9838-4942
Sponsor: Novo Nordisk A/S (Pharmaceutical company). Phase: Therapeutic confirmatory (Phase III). Countries: France (ongoing, recruitment ended), Ireland (ongoing, recruitment ended), Netherlands (ongoing, recruitment ended), Poland (ongoing, recruitment ended), Denmark (ongoing, recruitment ended), Bulgaria (ongoing, recruitment ended), Spain (ongoing, recruitment ended), Germany (ongoing, recruitment ended), Italy (ongoing, recruitment ended).
Therapeutic area(s): Diseases [C] - Nutritional and Metabolic Diseases [C18]
Gender: Female, Male. Age: 18-64 years, 65+ years. Enrolment: 2011.
Status: Ongoing, recruitment ended. Start date (EU): 2023-02-28. Decision date: 2024-08-16. Results received: No. Last updated: 2026-08-07.
Decision dates by country: BG: 2024-08-19, FR: 2024-08-20, IE: 2024-08-16, PL: 2024-08-30, NL: 2024-08-19, DE: 2024-08-19, DK: 2024-08-20, IT: 2024-09-02, ES: 2024-08-19

Condition(s): Cardiovascular disease
Product: cagrilintide semaglutide, cagrilintide semaglutide, cagrilintide semaglutide, cagrilintide semaglutide, Placebo + Placebo, cagrilintide semaglutide

Primary endpoint: Time to first occurrence of MACE, a composite endpoint consisting of: • CV death • non-fatal myocardial infarction • non-fatal stroke
Endpoint(s): CCI, CCI, Time to first occurrence of a composite endpoint consisting of: • Onset of persistent ≥40% reduction in eGFRcr (CKD EPI) compared with baseline • Onset of persistent eGFRcr (CKD-EPI) <15 mL/min/1.73 m2 • Initiation of chronic kidney replacement therapy (dialysis or kidney transplantation) • Kidney death • CV death, CCI, Time to first occurrence of an expanded MACE composite endpoint consisting of: • CV death • non-fatal myocardial infarction • non-fatal stroke • coronary revascularisation • unstable angina requiring hospitalisation, Time to first occurrence of a composite endpoint consisting of: • all-cause death • non-fatal myocardial infarction • non-fatal stroke, Time to first occurrence of myocardial infarction (fatal and non fatal), Time to first occurrence of stroke (fatal and non fatal), Relative change in body weight, Change in waist circumference, Change in systolic blood pressure (SBP), Change in diastolic blood pressure (DBP), ratio to baseline in lipids: • Total cholesterol • HDL cholesterol • LDL cholesterol • VLDL cholesterol • Triglycerides • Free fatty acids, Change in HbA1c, Change in SF-36v2: • Physical Component Summary score • Mental Component Summary score, Number of TESAEs, Number of event adjudication committee (EAC)-confirmed malignant neoplasms, Number of severe hypoglycaemic episodes (level 3) (only for participants with T2D at screening), Ratio to baseline in hsCRP, Ratio to baseline in TNF-α, Ratio to baseline in IL-6, Ratio to baseline in IL-1β, Change in pain intensity rated by Numerical Rating Scale (NRS), Change in Pittsburgh Sleep Quality Index (PSQI), Change in neuropathy status by baseline neuropathy group (painful neuropathy, painless neuropathy or no neuropathy), CCI, CCI, CCI, Time to first occurrence of a composite endpoint consisting of: • Onset of persistent macro albuminuria • Onset of persistent ≥40% reduction in eGFRcr (CKD EPI) compared with baseline • Onset of persistent eGFRcr (CKD-EPI) <15 mL/min/1.73 m2 • Initiation of chronic kidney replacement therapy (dialysis or kidney transplantation) • Kidney death, Change in eGFRcr (CKD-EPI), Ratio to baseline in UACR, Change in waist-to-height ratio

Source: https://euclinicaltrials.eu/ctis-public/view/2023-506924-94-00